EU clinical trial 2024-513995-16-00: A Phase 2/3, Open-label, Baseline-controlled, Multicenter, Long-term Study to Evaluate the Safety, Efficacy, and Pharmacokinetics of Vibegron in Pediatric Subjects 2 Years to < 18 Years of Age with Neurogenic Detrusor Overactivity (NDO) on Clean Intermittent Catheterization (CIC)
Protocol code: URO-901-3007
Sponsor: Sumitomo Pharma America Inc. (Pharmaceutical company). Phase: Phase II and Phase III (Integrated). Countries: Lithuania (authorised, recruiting), Croatia (authorised, recruiting), Latvia (ended), Denmark (authorised, recruiting), Romania (ongoing, recruiting), Belgium (authorised, recruiting), Slovakia (authorised, recruiting), Norway (authorised, recruiting), Poland (authorised, recruiting).
Therapeutic area(s): Diseases [C] - Pathological Conditions, Signs and Symptoms [C23]
Gender: Female, Male. Age: 0-17 years. Enrolment: 48.
Start date (EU): 2023-07-28. Decision date: 2024-07-22. Results received: No. Last updated: 2026-07-27.
Decision dates by country: RO: 2024-07-22, LV: 2024-07-22, HR: 2024-07-22, NO: 2025-07-30, DK: 2024-07-22, SK: 2024-07-22, BE: 2024-07-22, PL: 2025-08-11, LT: 2024-07-24

Condition(s): Neurogenic Detrusor Overactivity (NDO)
Product: Vibegron, Vibegron, Vibegron, Vibegron, Vibegron, Vibegron, Vibegron

Primary endpoint: Change from baseline at Study Week 32 (Optimized Treatment Week 24) in MCC based on filling urodynamics
Endpoint(s): Secondary Efficacy Endpoints: Based on Urodynamics: - Change from baseline at Study Week 20 (Optimized Treatment Week 12) in MCC - Change from baseline at Study Weeks 20 and 32 (Optimized Treatment Week 12 and 24) in: Number of overactive detrusor contractions until end of filling; Detrusor pressure at end of filling; Filling volume until first involuntary/hyperactive detrusor contraction; Bladder compliance, Secondary Efficacy Endpoints: Based on Bladder Diary: - Change from baseline at all applicable study visits in: average first morning catheterized volume; Average catheterized volume per catheterization; average maximum catheterized volume per day; Average maximum catheterized daytime volume; Average number of leakage episodes per day; Estimated number of dry days/7 days, Secondary Efficacy Endpoints: Based on Questionnaires: - Change from baseline at all applicable study visits in PIN-Q - Change from baseline at all applicable study visits in PGI-S Scale - CGI-C Scale assessment at all applicable study visits., Safety and Tolerability: - Incidence of AEs - Incidence of AESIs - Upper urinary tract ultrasound assessment - eGFR - Vital signs measured at clinic visits: pulse rate, systolic and diastolic blood pressure - 12-lead ECG, centrally read, Pharmacokinetics: - PK of vibegron in plasma: Cmax, tmax, AUCtau, Ctrough, t1/2, and CL/F

Source: https://euclinicaltrials.eu/ctis-public/view/2024-513995-16-00